EU clinical trial 2023-510082-10-00: KontRASt-02: A randomized, controlled, open label, phase III study evaluating the efficacy and safety of JDQ443 versus docetaxel in previously treated subjects with locally advanced or metastatic KRAS G12C mutant non-small cell lung cancer.
Protocol code: CJDQ443B12301
Sponsor: Novartis Pharma AG (Pharmaceutical company). Phase: Therapeutic confirmatory (Phase III). Countries: Romania (ended), Portugal (ended), Slovenia (ended), Hungary (ended), Spain (temporarily halted), Finland (ended), Italy (temporarily halted), Iceland (ended), Greece (ended).
Therapeutic area(s): Diseases [C] - Neoplasms [C04]
Gender: Female, Male. Age: 18-64 years, 65+ years. Enrolment: 68.
Start date (EU): 2022-09-05. Decision date: 2024-09-10. Results received: No. Last updated: 2026-06-29.
Decision dates by country: HU: 2024-09-10, PT: 2024-09-11, RO: 2024-09-25, FI: 2024-09-10, GR: 2024-11-26, IS: 2024-10-25, IT: 2024-09-30, SI: 2024-09-30, ES: 2024-09-16

Condition(s): Advanced non-small cell lung cancer harboring the KRAS G12C mutation
Product: JDQ443, DOCETAXEL

Primary endpoint: Progression free survival (PFS) per RECIST 1.1 as assessed by the investigator
Endpoint(s): Type, frequency and severity of adverse events, changes in laboratory values, vital signs, ECGs

Source: https://euclinicaltrials.eu/ctis-public/view/2023-510082-10-00